EU clinical trial 2024-515825-27-00: Neoadjuvant AXITINIB plus AVELUMAB for patients with localized RCC and a moderate to high risk of recurrence (N17JAV)
Sponsor: Het Nederlands Kanker Instituut-Antoni van Leeuwenhoek Ziekenhuis Stichting (Hospital/Clinic/Other health care facility). Phase: Therapeutic exploratory (Phase II). Countries: Netherlands (authorised, recruitment pending).
Therapeutic area(s): Diseases [C] - Neoplasms [C04]
Gender: Female, Male. Age: 18-64 years, 65+ years. Enrolment: 40.
Status: Authorised, recruitment pending. Decision date: 2024-07-11. Results received: No. Last updated: 2024-07-11.

Condition(s): renal cell carcinoma
Product: Bavencio 20 mg/mL concentrate for solution for infusion, Inlyta 5 mg film-coated tablets

Primary endpoint: The primary endpoint of this study is the rate of partial remission following neoadjuvant axitinib and avelumab.
Endpoint(s): Safety and adverse events of the combination of axitinib with avelumab, Long term follow up with DFS, OS, rate of metastasis and local recurrence, Clavien Dindo classification of surgical morbidity, Translational research

Source: https://euclinicaltrials.eu/ctis-public/view/2024-515825-27-00